EU clinical trial 2024-516392-33-00: Phase III study comparing Trabectedin (T) versus T plus tTF-NGR to entrap T inside the tumor in patients with metastatic and/or refractory soft tissue sarcoma (STS), Acronym: TRABTRAP
Protocol code: WWU19_0007
Sponsor: Universitaet Muenster (Educational Institution). Phase: Therapeutic confirmatory (Phase III). Countries: Germany (ongoing, recruiting).
Therapeutic area(s): Diseases [C] - Neoplasms [C04]
Gender: Female, Male. Age: 18-64 years, 65+ years. Enrolment: 126.
Status: Ongoing, recruiting. Start date (EU): 2021-09-17. Decision date: 2024-09-03. Results received: No. Last updated: 2026-08-09.

Condition(s): Patients (18-75 years) with metastatic and/or refractory soft-tissue sarcoma after failure of anthracycline-containing 1st line therapy or with contraindications to anthracyclines (CD13 positivity: grade >/= 1+)
Product: tTF-NGR

Primary endpoint: for the phase III randomized part: Progression-free survival (PFS) according to Response Evaluation Criteria in Solid Tumours in cancer immunotherapy trials (iRECIST) as judged by central blinded radiology. iRECIST evaluation because of the observation within preclinical studies and clinical cases, that intratumoral swelling by blood pooling and vascular isruption can occur and lead to pseudoprogressions. Central blinded assessment of PFS is considered the relevant primary efficacy endpoint.

Source: https://euclinicaltrials.eu/ctis-public/view/2024-516392-33-00